EU clinical trial 2024-511863-27-01: REBALANCE UC : impact of Fecal Microbiota Transplantation in Ulcerative Colitis (REBALANCE-UC)
Protocol code: P160931J
Sponsor: Assistance Publique Hopitaux De Paris (Hospital/Clinic/Other health care facility). Phase: Phase II and Phase III (Integrated). Countries: France (ongoing, recruitment ended).
Therapeutic area(s): Diseases [C] - Digestive System Diseases [C06]
Gender: Female, Male. Age: 18-64 years, 65+ years. Enrolment: 350.
Status: Ongoing, recruitment ended. Start date (EU): 2024-12-06. Decision date: 2024-12-06. Results received: No. Last updated: 2024-12-06.

Condition(s): Adult patients with ulcerative colitis diagnosed for at least 3 months
Product: Enema transplant of fecal microbiota, Placebo Enema transplant of fecal microbiota

Primary endpoint: Steroid-free clinical and endoscopic remission at week 12 is defined as a total Mayo score of 2 or lower and no subscore higher than 1 and mucosal healing defined as an endoscopic subscore of 0 or 1 (sigmoidoscopy).
Endpoint(s): Steroid-free clinical remission is defined as a Partial Mayo Clinic score of 0 or 1, Steroid-free endoscopic response is defined as a Mayo endoscopy subscore of 1 or less, with a reduction of at least 1 point from baseline, Steroid-free clinical remission is defined as a Partial Mayo Clinic score of 0 or 1, Steroid-free endoscopic remission is defined as Endoscopic Mayo Clinic subscore of 0., Microbiota composition and diversity assessed by 16s sequencing at week 12 and 24, compared to baseline and to healthy volunteers donor’s microbiota., Proportion of adverse events in each group (Abdominal pain, Nausea, vomiting, fever, modified intestinal transit, an episode of infection), Inflammatory biological parameter: CRP, fecal calprotectin, platelet number, Endoscopic lesions at coloscopy and sigmoidoscopy (week 12) by endoscopic Mayo score and UCEIS score

Source: https://euclinicaltrials.eu/ctis-public/view/2024-511863-27-01